EU clinical trial 2024-520138-31-00: PREFer: Phase II trial of anti-PD-1 antibody treatment and radiotherapy in early-stage favorable classic Hodgkin lymphoma
Protocol code: Uni-Koeln-5450
Sponsor: University Of Cologne (Educational Institution). Phase: Therapeutic exploratory (Phase II). Countries: Germany (ongoing, recruiting).
Therapeutic area(s): Diseases [C] - Neoplasms [C04]
Gender: Female, Male. Age: 18-64 years, 65+ years. Enrolment: 50.
Status: Ongoing, recruiting. Start date (EU): 2026-06-01. Decision date: 2026-02-10. Results received: No. Last updated: 2026-02-10.

Condition(s): Early-stage favorable classic Hodgkin lymphoma
Product: KEYTRUDA 25 mg/mL concentrate for solution for infusion

Primary endpoint: Progression-free survival (PFS) at 1 year
Endpoint(s): Remission status after pembrolizumab therapy and after consolidation Radiotherapy, Progression-free survival (PFS) at 2 years, Overall survival (OS) at 1 year and at 2 years, Adverse events during and after anti-PD-1 therapy, Patient-reported outcomes at baseline, during treatment and during follow-up, Rate of early discontinuation of trial treatment, Rate and types of HL-directed treatment administered in addition to trial treatment, Event-free survival (EFS) at 1 year and at 2 years

Source: https://euclinicaltrials.eu/ctis-public/view/2024-520138-31-00